EU clinical trial 2024-519600-27-00: Clinical performance study of a new diagnostic test for drug sensitivity evaluation in metastatic colorectal cancer
Protocol code: DSEE-CRC
Sponsor: Oncosyne AS (Pharmaceutical company). Phase: Therapeutic exploratory (Phase II). Countries: Norway (ongoing, recruiting).
Therapeutic area(s): Analytical, Diagnostic and Therapeutic Techniques and Equipment [E] - Diagnosis [E01]
Gender: Female, Male. Age: 18-64 years, 65+ years. Enrolment: 75.
Status: Ongoing, recruiting. Start date (EU): 2025-10-28. Decision date: 2025-04-29. Results received: No. Last updated: 2026-05-11.

Condition(s): metastatic colorectal cancer
Product: FLUOROURACIL

Primary endpoint: Proportion of patients with a successful biopsy yielding a µCAN report.
Endpoint(s): Proportion of patients with a successful biopsy yielding a µCAN report within 56 days (8 weeks)., Proportion of patients with a successful biopsy yielding a µCAN report with at least one drug therapy nomination., Frequency, intensity and seriousness of adverse events (AEs) related to device or study procedures., Frequency and nature of device deficiencies (DD)., Device user experience questionnaire.

Source: https://euclinicaltrials.eu/ctis-public/view/2024-519600-27-00